EU clinical trial 2024-515000-39-00: A phase I/II multicenter trial evaluating the association of hypofractionated stereotactic radiation therapy and the anti-PD-L1 Durvalumab (Medi4736) for patients with recurrent glioblastoma
Protocol code: 16TETE04
Sponsor: Oncopole Claudius Regaud (Hospital/Clinic/Other health care facility). Phase: Phase I and Phase II (Integrated)- Other. Countries: France (ended).
Therapeutic area(s): Diseases [C] - Neoplasms [C04]
Gender: Female, Male. Age: 18-64 years, 65+ years. Enrolment: 106.
Status: Ended. Start date (EU): 2017-01-17. End date (EU): 2024-11-02. Decision date: 2024-08-14. Results received: Yes. Last updated: 2025-03-21.

Condition(s): Recurrent glioblastoma.
Product: IMFINZI 50 mg/mL concentrate for solution for infusion.

Primary endpoint: PHASE I PART: The schema will be defined as safe if one patient or less (i.e. 0 or 1) among 6 present DLT., PHASE II PART: The primary endpoint of the phase II part of the study is the overall survival which is defined as the time from randomization to death from any cause. Patients alive at last follow-up news are censored at this date.
Endpoint(s): PHASE I PART: - Intracranial progression-free interval is defined by the time from inclusion to local or distant (outside the re-irradiated volume) progression. Patients without progression at last follow-up news are censored at this date., PHASE I PART:- Overall survival is defined as the time from inclusion to death from any cause. Patients alive at last follow-up news are censored at this date., PHASE I PART:- Safety and tolerability will be evaluated using the NCI-CTCAE Version 4.03., PHASE I PART:- Quality of life will be evaluated using EORTC QLQ-C30 and BN-20 questionnaires., PHASE I PART:- Neurologic and neurocognitive functions will be evaluated using NANO scale and MoCA tests., PHASE II PART: - Intracranial progression-free interval is defined by the time from randomization to local or distant (outside the re-irradiated volume) progression according to RANO criteria. Patients without progression at last follow-up news are censored at this date., PHASE II PART:- Immune-related intracranial progression-free interval is defined by the time from randomization to local or distant (outside the re-irradiated volume) progression (based on iRANO; Okada et al, 2015). Patients without progression at last follow-up news are censored at this date., PHASE II PART:- Acute and late toxicities will be evaluated using the NCI-CTCAE Version 4.03., PHASE II PART:- Quality of life will be evaluated using EORTC QLQ-C30 and BN-20 questionnaires., PHASE II PART:- Neurologic and neurocognitive functions will be evaluated using NANO scale and MoCA tests., PHASE II PART:- Time to QoL deterioration is defined as the time interval between randomization and first decrease in QoL score greater or equal to 5 points. Patients without such a QoL decrease will be censored at last follow-up news or at initiation of a new therapeutic strategy., PHASE II PART:- Time to neurocognitive deterioration is defined as the time interval between randomization and first of 3 points difference in MoCA as minimal clinically important difference. Patients without such a neurocognitive decrease will be censored at last follow-up news or at initiation of a new therapeutic strategy.

Source: https://euclinicaltrials.eu/ctis-public/view/2024-515000-39-00